EU clinical trial 2025-522819-42-01: BETARGET : Randomized trial of individualizing BETA-lactam taRGET combining therapeutic drug monitoring, minimal inhibitory concentration and model-based dose adjustment, in Intensive Care Units patients with gram negative bacilli infection
Protocol code: 35RC23_8883_BETARGET
Sponsor: Centre Hospitalier Universitaire De Rennes (Hospital/Clinic/Other health care facility). Phase: Phase III and phase IV (Integrated). Countries: France (authorised, recruitment pending).
Therapeutic area(s): Diseases [C] - Bacterial Infections and Mycoses [C01]
Gender: Female, Male. Age: 18-64 years, 65+ years. Enrolment: 672.
Status: Authorised, recruitment pending. Decision date: 2026-08-06. Results received: No. Last updated: 2026-08-06.

Condition(s): sepsis
Product: PIPERACILLIN, TAZOBACTAM, AMOXICILLIN, CEFOTAXIME, CEFEPIME DIHYDROCHLORIDE MONOHYDRATE, CEFTAZIDIME, PIPERACILLIN SODIUM, AVIBACTAM, CEFTAZIDIME, MEROPENEM TRIHYDRATE

Primary endpoint: Number of ICU free days at day 28 after inclusion. It is a composite endpoint combining survival at 28 days and the number of days in ICU.
Endpoint(s): Difference between SOFA score at day 1 and day 7 or last assessment before death or time to readiness for ICU discharge, Number of treatment support days among the ICU stay, and at maximum day 28: catecholamine, invasive mechanical ventilation, renal replacement therapy, Mortality up to 28 days, Emergence of multi-resistant or C3G resistant bacteria among group 3 enterobacterales on weekly screening samples or on clinical strains if there is an infection associated with treatment during the ICU stay, and at maximum day 28, Alive and with clinical cure assessed at day 14 or earlier in case of time to readiness for discharge from the ICU, Use of an antibiotic therapy other than the initial antibiotic therapy for a documented relapse or superinfection between the end of initial antibiotic therapy and time to readiness for discharge from the ICU, or at maximum day 28, Microbiological cure on day 3, defined as tracheal aspiration culture becoming negative on day 3, Presence of encephalopathy before day 7 or at last assessment before death, assessed by the ICDSC daily, Number and type of beta lactam dosage adjustments in the first 7 days, Number of days without antibiotic at day 28, defined as 28 – number of days of antibiotics, Beta-lactam concentration over MIC ratio during the first 7 days of antibiotics

Source: https://euclinicaltrials.eu/ctis-public/view/2025-522819-42-01